EU clinical trial 2025-523633-25-00: A Phase II, Open-Label, Single-Arm, Multicentre Study of Immunotherapy and non-invasive response evaluation in cutaneous squamous cell carcinoma as an organ preservation strategy: a proof of concept clinical study and translational correlates - INCEPT
Sponsor: Fondazione GONO Plus (Laboratory/Research/Testing facility). Phase: Therapeutic exploratory (Phase II). Countries: Italy (authorised, recruitment pending).
Therapeutic area(s): Diseases [C] - Neoplasms [C04]
Gender: Female, Male. Age: 18-64 years, 65+ years. Enrolment: 33.
Status: Authorised, recruitment pending. Decision date: 2026-07-14. Results received: No. Last updated: 2026-08-05.
Decision dates by country: IT: 2026-07-21

Condition(s): cutaneous squamous cell carcinoma
Product: LIBTAYO 350 mg concentrate for solution for infusion.

Primary endpoint: To describe the proportion of patients who do not require surgery at one year in the intention-to-treat (ITT) population.
Endpoint(s): a) Event free survival (EFS). EFS is defined as time from diagnosis until progression, relapse, unplanned re-treatment after initial immunotherapy, or death as a result of any cause. b) Relapse-free survival (RFS). c) Overall survival (OS)., a) Objective response rate per iPERCIST criteria. b) Proportion of confirmed pCR via biopsy or surgery., 3a) NCI-PRO-CTCAE outcome (a selection of them, specifically built according to most frequent symptoms in cSCC patients) at baseline, at the end of upfront cemiplimab treatment, 3 months after the end of treatment in the whole patient court and evaluation of differences among responder vs non-responder patients and among locally treated vs non locally treated patients., 3b) Decision regret scale score at the end of upfront cemiplimab treatment, 1 year after the end of treatment in the whole patient court and evaluation of differences among responder vs non-responder patients and among locally treated vs non locally treated patients.

Source: https://euclinicaltrials.eu/ctis-public/view/2025-523633-25-00